EU clinical trial 2023-503335-18-00: A Phase 1a/1b Study of ELVN-001 for the Treatment of Chronic Myeloid Leukemia
Protocol code: ELVN-001-101
Sponsor: Enliven Therapeutics Inc. (Pharmaceutical company). Phase: Human Pharmacology (Phase I)- First administration to humans. Countries: Spain (ongoing, recruiting), France (ongoing, recruiting), Germany (ongoing, recruiting), Belgium (ongoing, recruiting), Hungary (ongoing, recruiting), Italy (ongoing, recruiting), Netherlands (ongoing, recruiting), Poland (ongoing, recruiting).
Therapeutic area(s): Diseases [C] - Hemic and Lymphatic Diseases [C15]
Gender: Female, Male. Age: 18-64 years, 65+ years. Enrolment: 145.
Status: Ongoing, recruiting. Start date (EU): 2022-07-29. Decision date: 2024-05-17. Results received: No. Last updated: 2026-06-22.
Decision dates by country: ES: 2024-05-17, IT: 2025-05-07, BE: 2025-04-14, PL: 2025-05-13, FR: 2024-05-27, NL: 2025-04-30, DE: 2024-05-22, HU: 2025-04-24

Condition(s): Chronic myeloid leukemia

Source: https://euclinicaltrials.eu/ctis-public/view/2023-503335-18-00